EU clinical trial 2024-519403-10-00: A multicentre, prospective, open-label, non-comparative study to evaluate menstrual bleeding typology, tolerability, and compliance during a monophasic hormonal contraceptive treatment with norgestimate + ethinylestradiol in Italy.”
Protocol code: EFFI2021/01
Sponsor: Italfarmaco S.p.A. (Pharmaceutical company). Phase: Therapeutic use (Phase IV). Countries: Italy (authorised, recruitment pending).
Therapeutic area(s): Not possible to specify
Gender: Female. Age: 18-64 years. Enrolment: 240.
Status: Authorised, recruitment pending. Decision date: 2025-02-03. Results received: No. Last updated: 2026-06-22.

Condition(s): Female contraception.
Product: EFFIMIA 0,250 mg/0,035mg, Compresse

Primary endpoint: Cycle control evaluation parameter: breakthrough bleeding (bleeding and/or spotting between cyclically regular onset of menses) by calculating the intermenstrual spotting occurrence rate at sixth cycle only (value to be intended as not cumulative with values from the other 5 cycles taking place during the whole study period). A comparison within group will be performed at V3 with respect to Baseline (V1).
Endpoint(s): Cycle control evaluation parameters: frequency, duration, regularity, flow volume (subject determined), unscheduled bleeding. A comparison within group will be performed at V2 and V3 with respect to Baseline (V1)., Global Acne Grading System (GAGS). A comparison within group will be performed at V2 and V3 with respect to Baseline (V1)., Profile of Mood State (POMS). A comparison within group will be performed at V2 and V3 with respect to Baseline (V1)., Female Sexual Function Index (FSFI). A comparison within group will be performed at V2 and V3 with respect to Baseline (V1)., Dysmenorrhea - VAS scale. A comparison within group will be performed at V2 and V3 with respect to Baseline (V1)., Compliance (adherence to treatment)., Contraception failure rate during the 6-month treatment; the contraception failure rate is defined as the proportion of women who will become pregnant during the study period. The reasons for any contraception failure occurrence will be identified and listed (e.g., discontinuation or poor compliance)., Metabolic and hormonal parameters

Source: https://euclinicaltrials.eu/ctis-public/view/2024-519403-10-00